EU clinical trial 2025-521358-41-00: Phase II RAINSPOT: a multicentric open label trial of Zolbetuximab-Paclitaxel-Ramucirumab in second line setting for CLDN18.2 positive gastro-esophageal adenocarcinoma
Sponsor: UZ Leuven (Hospital/Clinic/Other health care facility). Phase: Therapeutic exploratory (Phase II). Countries: Belgium (ongoing, recruiting).
Therapeutic area(s): Diseases [C] - Neoplasms [C04]; Diseases [C] - Digestive System Diseases [C06]
Gender: Female, Male. Age: 18-64 years, 65+ years. Enrolment: 200.
Status: Ongoing, recruiting. Start date (EU): 2025-12-11. Decision date: 2025-09-17. Results received: No. Last updated: 2026-02-13.

Condition(s): CLDN18.2 positive gastro-esophageal adenocarcinoma
Product: Vyloy 100 mg powder for concentrate for solution for infusion.

Primary endpoint: The primary endpoint is OS (overall survival), which is defined as the time from the date of signature of informed consent until death from any cause. Patients starting a subsequent line of treatment after study discontinuation will not be censored for survival at the start of this subsequent treatment. Subjects who are still alive at the time of analysis will be censored at the last day known to be alive.
Endpoint(s): Secondary Endpoints PFS, which is defined as the time from the date of signature of informed consent until the date of radiological PD (per Response Evaluation Criteria in Solid Tumours [RECIST] 1.1) or death from any cause, whichever is earliest. Patients unprogressed at time of discontinuation for other causes, starting a subsequent line of treatment will be censored for progression at the start of this subsequent treatment., Safety will be assessed and reported continuously as per regulations.

Source: https://euclinicaltrials.eu/ctis-public/view/2025-521358-41-00